EU clinical trial 2024-514506-32-00: A Phase III, Randomised, Double-Blind, Placebo-controlled, Event driven Study to Evaluate the Effect of Baxdrostat in Combination with Dapagliflozin Compared with Dapagliflozin Alone on the Risk of Incident Heart Failure and Cardiovascular Death in Participants with Increased Risk of Developing Heart Failure
Protocol code: D6973C00001
Sponsor: AstraZeneca AB (Pharmaceutical company). Phase: Therapeutic confirmatory (Phase III). Countries: Germany (ongoing, recruiting), Spain (ongoing, recruiting), Romania (ongoing, recruiting), Sweden (ongoing, recruiting), Greece (ongoing, recruiting), Poland (ongoing, recruiting), Denmark (ongoing, recruiting), Slovakia (ongoing, recruiting), Bulgaria (ongoing, recruiting), France (ongoing, recruiting), Czechia (ongoing, recruiting), Hungary (ongoing, recruiting), Italy (ongoing, recruiting), Netherlands (ongoing, recruiting).
Therapeutic area(s): Diseases [C] - Cardiovascular Diseases [C14]
Gender: Female, Male. Age: 18-64 years, 65+ years. Enrolment: 3868.
Status: Ongoing, recruiting. Start date (EU): 2025-05-06. Decision date: 2025-04-14. Results received: No. Last updated: 2026-07-24.
Decision dates by country: PL: 2025-04-22, GR: 2025-04-15, BG: 2025-04-17, CZ: 2025-04-15, DK: 2025-04-28, FR: 2025-04-15, DE: 2025-04-16, HU: 2025-04-16, IT: 2025-04-16, RO: 2025-04-22, ES: 2025-04-14, SE: 2025-04-15, NL: 2025-04-22, SK: 2025-04-14

Condition(s): Prevention of Heart failure
Product: Forxiga 10 mg film-coated tablets, Baxdrostat, Baxdrostat, Baxdrostat, Baxdrostat Placebo

Primary endpoint: Time to first occurrence of any of the components of the composite of: • Hospitalisation for HF • HF without hospitalisation • CV death
Endpoint(s): Time to first occurrence of any of the components of the composite of: • Hospitalisation for HF • CV death, Time to first occurrence of any of the components of the composite of: • Hospitalisation for HF • HF without hospitalisation, Time to first occurrence of any of the components of the composite of: • CV death • MI • Stroke • Hospitalisation for HF, Time to CV death, Time to all-cause death

Source: https://euclinicaltrials.eu/ctis-public/view/2024-514506-32-00